EU clinical trial 2026-525619-15-00: A study to assess the safety, and blood levels of CTX-187 after single and repeated intravenous doses in healthy volunteers and patients with bacterial infection
Protocol code: CTX-187-101
Sponsor: Centauri Therapeutics Limited (Pharmaceutical company). Phase: Human Pharmacology (Phase I)- First administration to humans. Countries: Netherlands (ongoing, recruiting).
Therapeutic area(s): Diseases [C] - Bacterial Infections and Mycoses [C01]
Gender: Female, Male. Age: 18-64 years, 65+ years. Enrolment: 68.
Status: Ongoing, recruiting. Start date (EU): 2026-05-22. Decision date: 2026-04-30. Results received: No. Last updated: 2026-04-30.

Condition(s): Bacterial Infection

Source: https://euclinicaltrials.eu/ctis-public/view/2026-525619-15-00